EU clinical trial 2023-506715-18-00: Circulating tumour DNA based decision for adjuvant treatment in colon cancer stage II evaluation (CIRCULATE) AIO-KRK-0217.
Protocol code: TUD-CIRC01-071
Sponsor: Technische Universitat Dresden (Educational Institution). Phase: Therapeutic confirmatory (Phase III). Countries: Germany (ended), Austria (ended).
Therapeutic area(s): Diseases [C] - Neoplasms [C04]
Gender: Female, Male. Age: 18-64 years, 65+ years. Enrolment: 140.
Status: Ended. Start date (EU): 2019-12-04. End date (EU): 2026-01-31. Decision date: 2024-04-17. Results received: No. Last updated: 2026-01-15.
Decision dates by country: AT: 2024-06-06, DE: 2024-04-17

Condition(s): colon cancer stage II, rectal cancer stage II
Product: CAPECITABINE

Primary endpoint: Disease free survival of ctDNA positive patients randomised to “chemo- therapy” vs. “follow-up”, measured from randomisation to any recur- rence, metastasis, second colorectal or non colorectal cancer and death from any cause. The primary endpoint will be tested in all randomised ctDNA positive patients and be evaluated by a stratified log rank test.
Endpoint(s): Overall survival in ctDNApos patients with adjuvant therapy vs follow-up, measured from randomisation to death from any cause, in all randomised ctDNA positive patients and be evalu- ated by a stratified log rank test., Disease free survival in ctDNAneg patients randomised to follow up (rate of patients disease free and alive 3 years after randomisation according to Kaplan-Meier estimation with 95% CI, intention-to-treat analysis). Any recurrence, metastasis, second colorectal or non-colorectal cancer and death from any cause is regarded as event, Overall survival in ctDNAneg patients randomised to “follow up” (rate of patients alive after 5 years after randomisation according to Kaplan-Meier estimation with 95% CI)., Disease free and overall survival of ctDNApos vs. ctDNAneg pa- tients randomized to „follow-up“ (measured from randomisation to the event in an intention-to-treat analysis by stratified log rank test). Any recurrence, metastasis, second colorectal or non-colorectal cancer and death from any cause are regarded as event for DFS. Death of any cause will be regarded as event for overall survival., Site of metastases (lymph node vs. peritoneal/local recurrence vs other) in ctDNApos vs. ctDNAneg patients who have a recur- rence / metastases., Frequency of adverse events from start of chemotherapy until 30 days after chemotherapy (descriptive analysis for patients randomised to “chemotherapy” who have received at least one dose of chemotherapy)., Rate of patients in which ctDNA becomes non-measurable during or after chemotherapy (measured in ctDNApos patients receiving chemotherapy) and time to the first negative sample, ctDNA level before recurrence, DFS according to ctDNA level at time of enrolment, Correlation of further molecular tissue and plasma marker to the risk of recurrence or metastases or the effect of chemo- therapy (exploratory analysis)

Source: https://euclinicaltrials.eu/ctis-public/view/2023-506715-18-00